EU clinical trial 2024-510773-20-00: An Open-label Extension Study to Assess the Long-term Safety and Tolerability of Adjunctive KarXT in Subjects with Inadequately Controlled Symptoms of Schizophrenia
Protocol code: KAR-013
Sponsor: Karuna Therapeutics Inc. (Pharmaceutical company). Phase: Therapeutic confirmatory (Phase III). Countries: Bulgaria (ended).
Therapeutic area(s): Psychiatry and Psychology [F] - Mental Disorders [F03]
Gender: Female, Male. Age: 18-64 years, 65+ years. Enrolment: 50.
Status: Ended. Start date (EU): 2023-06-12. End date (EU): 2026-03-10. End date: 2026-03-25. Decision date: 2024-08-06. Results received: No. Last updated: 2025-12-19.

Condition(s): Schizophrenia
Product: KarXT, KarXT, KarXT, KarXT

Primary endpoint: Incidence of treatment-emergent adverse events (TEAEs)
Endpoint(s): Incidence of serious TEAEs, Incidence of TEAEs leading to discontinuation of study drug

Source: https://euclinicaltrials.eu/ctis-public/view/2024-510773-20-00